EU clinical trial 2024-512921-10-00: First-in-human Phase 1/2 Trial of EGL-001 in Adult Patients with Selected Advanced and/or Metastatic Solid Tumors (Protocol Number : EGL-121)
Protocol code: EGL-121
Sponsor: Egle Therapeutics (Pharmaceutical company). Phase: Human Pharmacology (Phase I)- First administration to humans. Countries: Spain (ongoing, recruiting), France (ongoing, recruiting).
Therapeutic area(s): Not possible to specify
Gender: Female, Male. Age: 18-64 years, 65+ years. Enrolment: 62.
Status: Ongoing, recruiting. Start date (EU): 2024-09-27. Decision date: 2024-09-03. Results received: No. Last updated: 2026-03-27.
Decision dates by country: FR: 2024-09-03, ES: 2024-09-03

Condition(s): Advanced and/or Metastatic Solid Tumors
Product: EGL-001, KEYTRUDA 25 mg/mL concentrate for solution for infusion

Primary endpoint: Dose-limiting toxicities (DLTs) when patients are receiving weekly administration of EGL-001 and proportion of patients with adverse events (AEs), treatment-emergent AEs (TEAEs), and serious AEs (SAEs) between the first dose of study drug and up to 90 days after the last dose of study drug., Proportion of patients with complete response (CR) or partial response (PR).
Endpoint(s): Efficacy assessment based on Overall response rate (ORR), Disease control rate (DCR), Duration of overall response (DoR), Progression-free survival (PFS), Overall survival (OS)., The proportion of patients with adverse events (AEs), treatment-emergent adverse events (TEAEs), and Serious adverse Events (SAEs) between the first dose of study drug and up to 90 days after the last dose of study drug.

Source: https://euclinicaltrials.eu/ctis-public/view/2024-512921-10-00